EU clinical trial 2023-509718-12-01: Randomized controlled clinical trial on prophylactic treatment of constipation with polyethylene glycol with electrolytes in the critically ill child.
Protocol code: PEM3350
Sponsor: Hospital General Universitario Gregorio Maranon (Hospital/Clinic/Other health care facility). Phase: Therapeutic confirmatory (Phase III). Countries: Spain (ended).
Therapeutic area(s): Not possible to specify
Gender: Female, Male. Age: 0-17 years. Enrolment: 233.
Status: Ended. Start date (EU): 2025-05-09. End date (EU): 2026-06-24. Decision date: 2025-02-04. Results received: No. Last updated: 2025-02-04.

Condition(s): constipation
Product: Movicol Pediátrico Sabor Neutro 6,9 g polvo para solución oral en sobre.

Primary endpoint: - Efficacy assessment: the primary endpoint is stool output.
Endpoint(s): • Safety assessment: any adverse events, Assessment of stool consistency: the validated Bristol scale will be used.

Source: https://euclinicaltrials.eu/ctis-public/view/2023-509718-12-01